EU clinical trial 2024-519003-99-00: FESTIVAL_Fecal transplantation in Hidradenitis suppurativa : a pilot study
Protocol code: RBHP 2023 BUISSON
Sponsor: University Hospital Of Clermont-Ferrand (Hospital/Clinic/Other health care facility). Phase: Therapeutic exploratory (Phase II). Countries: France (authorised, recruitment pending).
Therapeutic area(s): Diseases [C] - Skin and Connective Tissue Diseases [C17]
Gender: Female, Male. Age: 18-64 years, 65+ years. Enrolment: 24.
Status: Authorised, recruitment pending. Decision date: 2025-06-24. Results received: No. Last updated: 2025-11-07.

Condition(s): Hidrdenitis suppurative
Product: Transplant microbiote fécal

Primary endpoint: Improvement of at least 55% in the IHS4 score (score evaluating the number of nodules, abscesses and fistulas with weighting according to the lesion) compared to the baseline state at the 12th week post FMT (D104 +- 2 days)
Endpoint(s): Improvement of at least 55% in the IHS4 score (score evaluating the number of nodules, abscesses and fistulas with weighting according to the lesion) compared to the baseline state at the 24th week post FMT, Improvement of at least 50% of lesions (nodules and abscesses) without new draining fistula or abscess (HiSCR50 score) at 12 and 24 weeks post-FMT, Improvement of the HSPGA score compared to the base state by 2 ranks (for example change from severe to mild score), Improvement in pain (VAS) at 12 and 24 weeks post-FMT, Improved flow (VAS) at 12 and 24 weeks post-FMT, Improvement in quality of life (DLQI) at 12 and 24 weeks post-FMT, Number and type of side effects: any adverse event (of any grade according to the CTCAE) that may be linked to FMT must be reported, in particular abdominal pain, transit disorders and bacterial translocations from the day of FMT until 6 months post FMT, Analysis of the fecal microbiota of patients at inclusion and at the 12th week post FMT by sequencing the gene encoding the RNA of the small 16S subunit of the bacterial ribosome (16S RNA), Analysis of the fecal microbiota of donors at the first stool donation by sequencing the gene coding for the RNA of the small 16S subunit of the bacterial ribosome (16S RNA)

Source: https://euclinicaltrials.eu/ctis-public/view/2024-519003-99-00